EU clinical trial 2023-505167-36-00: An Open-Label, Multi-Centre, Randomised Study to Investigate Integrase Inhibitor Versus Boosted Protease Inhibitor Antiretroviral Therapy for Patients with Advanced HIV Disease -The Late Presenter Treatment Optimisation Study (LAPTOP)-
Protocol code: NEAT44
Sponsor: NEAT ID Foundation (Patient organisation/association). Phase: Therapeutic confirmatory (Phase III). Countries: Spain (ended), Ireland (ended), Italy (ended), Belgium (ended), Germany (ended), France (ended).
Therapeutic area(s): Diseases [C] - Virus Diseases [C02]
Gender: Female, Male. Age: 18-64 years, 65+ years. Enrolment: 357.
Status: Ended. Start date (EU): 2019-08-05. End date (EU): 2024-06-17. Decision date: 2023-11-02. Results received: Yes. Last updated: 2024-04-08.
Decision dates by country: BE: 2023-11-06, FR: 2023-11-02, DE: 2023-11-07, IE: 2023-11-02, IT: 2023-11-03, ES: 2023-11-02

Condition(s): Patients who present late on during their acquisition of the HIV-1 (Human Immunodeficiency Virus)
Product: Symtuza 800 mg/150 mg/200 mg/10 mg film-coated tablets, Biktarvy 50 mg/200 mg/25 mg film-coated tablets, Biktarvy 50 mg/200 mg/25 mg film-coated tablets

Primary endpoint: Time to failure, as the first occurrence of specified virological or clinical reasons.
Endpoint(s): Proportion of patients with HIV-RNA viral load < 50 copies/mL at week 24, 36, 48, HIV-1 drug resistance at confirmed virological failure (genotype), Time to reach CD4 count > 200/μL (first measurement), Proportion of patients with CD4 cell count < 200 μL and < 350μL at week 4, 8, 12, 24, 36, 48, CD4/CD8 ratio at week 4, 8, 12, 24, 36, 48, Incidence of IRIS in the two arms through week 48, Incidence and duration of hospitalisation, rate of relapse of specific OI/BI through week 48, Safety and tolerability, measured by Grade 2, 3 and 4 signs and symptoms and laboratory toxicities through week 48, ART and OI/BI treatment changes and dose modifications due to toxicities and DDI with ART, and IRIS through week 48, Health care resource use, including total inpatient days and emergency room visits through week 48, QOL and functional status outcomes, including overall self-reported QOL and functional status compared in the two groups at week 48, Discontinuation or modification of study medication due to insufficient virological response, resistance mutations at baseline, or resistance mutation development before week 48

Source: https://euclinicaltrials.eu/ctis-public/view/2023-505167-36-00